EU clinical trial 2025-524720-22-00: Prevention of radiation-induced salivary gland damage by botulinum toxin application in patients with head and neck cancers
Sponsor: Fakultni Nemocnice Kralovske Vinohrady (Hospital/Clinic/Other health care facility). Phase: Therapeutic exploratory (Phase II). Countries: Czechia (authorised, recruitment pending).
Therapeutic area(s): Diseases [C] - Otorhinolaryngologic Diseases [C09]
Gender: Female, Male. Age: 18-64 years, 65+ years. Enrolment: 40.
Status: Authorised, recruitment pending. Decision date: 2026-06-02. Results received: No. Last updated: 2026-06-02.

Condition(s): patients with head and neck squamous cell carcinoma (HNSCC)
Product: BOTOX 100 jednotek definovaných dle Allerganu prášek pro injekční roztok

Primary endpoint: Change in salivary gland function assessed by dynamic Tc99m scintigraphy (excretory fraction), comparing values before and after radiotherapy (biomarker of gland function).
Endpoint(s): Quantitative change in salivary secretion measured by Škach’s test (stimulated and unstimulated) (biomarker of gland function)., Change in ultrasound parameters of salivary glands (gland volume and echostructure) (biomarker of gland structure)., Patient-reported xerostomia assessed by the Xerostomia Questionnaire (XQ)., Quality of life assessed by EORTC QLQ-C30., Safety and tolerability of BoNT/A assessed by: (i) incidence of adverse events related to BoNT/A, (ii) severity of adverse events (CTCAE grading), (iii) occurrence of local complications at the injection site.

Source: https://euclinicaltrials.eu/ctis-public/view/2025-524720-22-00